EU clinical trial 2024-513870-23-00: Randomized Open-Label Phase III Study of Sacituzumab Govitecan Versus Treatment of Physician’s Choice in Subjects with Metastatic or Locally Advanced Unresectable Urothelial Cancer
Protocol code: IMMU-132-13
Sponsor: Gilead Sciences Inc. (Pharmaceutical company). Phase: Therapeutic confirmatory (Phase III). Countries: Italy (ended), France (ended), Sweden (ended), Belgium (ended), Greece (ended), Ireland (ended), Germany (ended), Spain (ended).
Therapeutic area(s): Diseases [C] - Neoplasms [C04]
Gender: Female, Male. Age: 18-64 years, 65+ years. Enrolment: 391.
Status: Ended. Start date (EU): 2021-06-28. End date (EU): 2025-05-21. End date: 2025-07-04. Decision date: 2024-10-29. Results received: Yes. Last updated: 2025-05-13.
Decision dates by country: SE: 2024-10-29, GR: 2025-01-27, IE: 2024-10-30, FR: 2024-11-14, DE: 2024-11-04, BE: 2024-10-29, IT: 2024-11-11, ES: 2024-10-29

Condition(s): Locally Advanced or Metastatic Unresectable Urothelial Cancer
Product: Paclitaxel 6 mg/mL concentrate for solution for infusion, Javlor 25 mg/mL concentrate for solution for infusion, Trodelvy 200 mg powder for concentrate for solution for infusion, Docetaxel Accord 80 mg/4 ml concentrate for solution for infusion

Primary endpoint: OS
Endpoint(s): PFS by investigator assessment and BICR using RECIST v1.1, ORR, CBR and DOR by investigator assessment and BICR using RECIST v1.1, Safety and tolerability evaluated by AEs, SAEs, and laboratory changes, Change from baseline in the physical functioning, global health status, pain, and fatigue scales of the EORTC QLQ-C30 score

Source: https://euclinicaltrials.eu/ctis-public/view/2024-513870-23-00